EU clinical trial 2023-506240-16-00: A Phase 1/2, Open-label Study Evaluating the Efficacy, Safety, and Pharmacokinetics (PK) of Luveltamab Tazevibulin (STRO-002) in Infants and Children < 12 years of age with CBFA2T3::GLIS2 Acute Myeloid Leukemia (AML)
Protocol code: REFRaME-P1
Sponsor: Sutro Biopharma Inc. (Pharmaceutical company). Phase: Phase I and Phase II (Integrated)- Other. Countries: Spain (ended), Denmark (ended), Netherlands (ended), Germany (ended), France (ended), Austria (ended), Italy (ended).
Therapeutic area(s): Diseases [C] - Hemic and Lymphatic Diseases [C15]; Diseases [C] - Neoplasms [C04]
Gender: Female, Male. Age: 0-17 years. Enrolment: 14.
Status: Ended. End date (EU): 2025-04-04. Decision date: 2024-10-21. Results received: No. Last updated: 2025-02-12.
Decision dates by country: AT: 2024-10-24, DK: 2024-10-21, ES: 2024-10-22, NL: 2024-10-28, FR: 2024-10-22, IT: 2025-01-13, DE: 2024-11-18

Condition(s): Acute Myeloid Leukemia (AML)

Primary endpoint: Complete remission (CR) rate
Endpoint(s): Duration of CR, Response rate including complete remission with partial hematologic recovery (CRh) rate [CR + CRh], Event-free survival (EFS), Relapse-free survival (RFS), Overall survival (OS), Incidence and severity of AEs and clinical laboratory abnormalities per NCI CTCAE v5.0., Concentration of luveltamab tazevibulin (ADC, TAb, and SC209) in the blood., Incidence of ADAs

Source: https://euclinicaltrials.eu/ctis-public/view/2023-506240-16-00